EU clinical trial 2023-507728-22-00: A Study to Evaluate the Safety, Tolerability, Pharmacokinetics, Pharmacodynamics, and Efficacy of Subcutaneous Glofitamab following Obinutuzumab Pretreatment in Patients with Relapsed or Refractory B-Cell Non-Hodgkin Lymphoma
Protocol code: BP43015
Sponsor: F. Hoffmann-La Roche AG (Pharmaceutical company). Phase: Human Pharmacology (Phase I)- Other. Countries: Italy (ongoing, recruiting), Spain (ongoing, recruiting), Belgium (ongoing, recruiting), Poland (ongoing, recruiting), Denmark (ongoing, recruiting).
Therapeutic area(s): Diseases [C] - Neoplasms [C04]
Gender: Female, Male. Age: 18-64 years, 65+ years. Enrolment: 73.
Status: Ongoing, recruiting. Start date (EU): 2021-06-25. Decision date: 2024-06-25. Results received: No. Last updated: 2026-07-06.
Decision dates by country: IT: 2024-07-03, ES: 2024-06-27, PL: 2024-07-01, BE: 2024-06-25, DK: 2024-06-26

Condition(s): Relapsed or Refractory B-Cell Non-Hodgkin Lymphoma

Source: https://euclinicaltrials.eu/ctis-public/view/2023-507728-22-00